EU clinical trial 2025-523149-80-00: KARMA - INtenSive care TreAtmeNT with adjuvant KetAmine and Recovery after Mechanical ventilAtion: a multicenter doubleblind randomized controlled trial
Protocol code: APHP240938
Sponsor: Assistance Publique Hopitaux De Paris (Hospital/Clinic/Other health care facility). Phase: Phase II and Phase III (Integrated). Countries: France (authorised, recruitment pending).
Therapeutic area(s): Diseases [C] - Respiratory Tract Diseases [C08]
Gender: Female, Male. Age: 18-64 years, 65+ years. Enrolment: 640.
Status: Authorised, recruitment pending. Decision date: 2026-04-20. Results received: No. Last updated: 2026-06-17.

Condition(s): Adult patients admitted to the ICU and receiving unplanned invasive mechanical ventilation
Product: SODIUM CHLORIDE, KETAMINE RENAUDIN 50 mg/ml, solution injectable

Primary endpoint: The primary endpoint will be the number of days patients are alive and spent at home at 60 days after drug or placebo initiation. This endpoint will be collected by an independent research assistant, blinded to randomization groups and not involved in data monitoring onsite.
Endpoint(s): The number of days alive free of encephalopathy (coma or delirium measured on the CAM-ICU) during 14 days after randomization, The number of days spent alive without invasive mechanical ventilation (ventilation-free days) at 60 days;, The number of days spent alive without infusion norepinephrine or inotropes infusion during ICU stay (vasopressors-free days) at 60 days;, Mortality, defined by the prevalence of all-cause deaths at 60 and 90 days;, Toxicité rénale, définie par la proportion de patients atteignant un stade KDIGO ≥2 à 60 jours ;, Liver toxicity, defined by the highest bilirubin and phosphatase alkaline level during the first 60 days;, Quantification of opioid and sedative consumption during the treatment period, in each arm during the first 14 days., Mean daily pain (BPS) and sedation (RASS) scores, in each arm during the first 14 days, Cumulative incidence of hallucination events during 14 days after randomization, Presence of anxiety and depression, defined by a score ≥11 on the anxiety and depression components of the Hospital Anxiety and Depression scale, respectively at 90 days; (tertiary outcome), Acute posttraumatic stressdisorder (PTSD)-related (measured on the ICU memory tool) at 90 days. (tertiary outcome)

Source: https://euclinicaltrials.eu/ctis-public/view/2025-523149-80-00